EU clinical trial 2024-516819-24-00: CAR-T cells in systemic B cell mediated autoimmune disease - CASTLE
Protocol code: M-2024-435
Sponsor: Miltenyi Biomedicine GmbH (Pharmaceutical company). Phase: Phase I and Phase II (Integrated)- Other. Countries: Germany (ongoing, recruiting).
Therapeutic area(s): Diseases [C] - Immune System Diseases [C20]; Diseases [C] - Skin and Connective Tissue Diseases [C17]; Diseases [C] - Musculoskeletal Diseases [C05]
Gender: Female, Male. Age: 18-64 years, 65+ years. Enrolment: 33.
Status: Ongoing, recruiting. Start date (EU): 2023-05-16. Decision date: 2024-08-15. Results received: No. Last updated: 2025-07-08.

Condition(s): Systemic Sclerosis, Idiopathic Inflammatory Myopathy, Systemic Lupus Erythematosus
Product: MB-CART19.1

Primary endpoint: Incidence and grading of severity (graded 0-4) of Cytokine Release Syndrome (CRS) and of CAR T cell Associated Neurotoxicity Syndrome (ICANS) within the first 4 weeks after ATMP administration
Endpoint(s): • Overall Response Rate (ORR) at week 24 measured by specific disease activity composite indexes, each of them validated for the specific disease: - SLE: Fulfillment of DORIS remission criteria of SLE at week 24., • Overall Response Rate (ORR) at week 24 measured by specific disease activity composite indexes, each of them validated for the specific disease: - SSc: No progression of interstitial lung disease with worsening of forced vital capacity (FVC)1 (>10%) or worsening of FVC1 (5-10%) plus increase in respiratory symptoms or worsening of FVC1 (5-10%) plus progression of high-resolution computed tomography changes after 24 weeks., • Overall Response Rate (ORR) at week 24 measured by specific disease activity composite indexes, each of them validated for the specific disease: - IIM: 2016 ACR/EULAR Moderate or Major Response. No progression of interstitial lung disease with worsening of FVC1 (>10%) or worsening of FVC1 (5-10%) plus increase in respiratory symptoms or worsening of FVC1 (5-10%) plus progression of high-resolution computed tomography changes after 24 weeks., • Duration of persistence of CAR T cells in the peripheral blood, • Duration of B cell depletion in the peripheral blood, • Levels of respective serum autoantibodies at week 24 including incidence of seroconversion - SLE: antinuclear antibodies (ANA), anti-double-stranded (ds)DNA, anti-nucleosomes, anti-Sm, anti-cardiolipin IgG, C3 C4, • Levels of respective serum autoantibodies at week 24 including incidence of seroconversion - SSc: ANA, anti-SCL70, anti-RNA polymerase III, anti-topoisomerase, • Levels of respective serum autoantibodies at week 24 including incidence of seroconversion - IIM: ANA, anti-Mi2, anti-Tif1, anti-MDA5, anti-Jo1, anti-NXP2, • Expansion of CAR T cells in the patient over time, • Success of the manufacturing process by Good Manufacturing Practice (GMP) certification of the product, • General: - Patient’s Global Assessment (PtGA) of disease activity (visual analogue scale [VAS] 0-100mm), • General: - Physician’s Global Assessment (PhGA) of disease activity (VAS 0-100mm), • General: - Health Assessment Questionnaire – Disease Index (HAQ-DI), • General: - Functional Assessment of Chronic Illness Therapy - Fatigue (FACIT Fatigue), • General: - Core Quality of Life (EORTC QLQ-C30), • General: - Extension phase only: incidence and severity of Adverse Events after reduced LD, • SLE: - British Isles Lupus Assessment Group (BILAG) index, • SLE: - Systemic Lupus Erythematosus Disease Activity Index (SLEDAI), • SSc: - modified Rodnan Skin Score (mRSS), • IIM: - Physician’s global assessment (PhGA) of extramuscular activity, • IIM: - Manual Muscle Testing (MMT)

Source: https://euclinicaltrials.eu/ctis-public/view/2024-516819-24-00